EU clinical trial 2024-519834-21-00: A trial to learn if itraconazole and carbamazepine affect how AZD5462 moves throughout the bodies of healthy adults
Protocol code: AZD5462-D9090C00012
Sponsor: AstraZeneca AB (Pharmaceutical company). Phase: Human Pharmacology (Phase I)- Other. Countries: Germany (ended).
Therapeutic area(s): Diseases [C] - Cardiovascular Diseases [C14]
Gender: Female, Male. Age: 18-64 years. Enrolment: 42.
Status: Ended. End date (EU): 2025-07-14. Decision date: 2025-04-22. Results received: No. Last updated: 2025-04-22.

Condition(s): Chronic Heart Failure

Source: https://euclinicaltrials.eu/ctis-public/view/2024-519834-21-00